EU clinical trial 2023-508924-36-00: A Multicentre, Randomized, Double-blind, Placebo-controlled, phase III study to evaluate the efficacy and safety of Pioglitazone co-administration in patients with type II diabetes with insufficient glycemic control with Metformin and Empagliflozin combination therapy
Protocol code: CT-L03-301
Sponsor: Celltrion Inc. (Pharmaceutical company). Phase: Therapeutic confirmatory (Phase III). Countries: Poland (ended).
Therapeutic area(s): Diseases [C] - Nutritional and Metabolic Diseases [C18]
Gender: Female, Male. Age: 18-64 years, 65+ years. Enrolment: 224.
Status: Ended. Start date (EU): 2024-08-20. End date (EU): 2026-04-01. End date: 2026-05-04. Decision date: 2024-05-27. Results received: No. Last updated: 2026-04-20.

Condition(s): Type 2 diabetes mellitus (T2DM)
Product: Pioglitazone, EMPAGLIFLOZIN, METFORMIN HYDROCHLORIDE, GLIMEPIRIDE, GLICLAZIDE, METFORMIN HYDROCHLORIDE, GLIPIZIDE, METFORMIN HYDROCHLORIDE, EMPAGLIFLOZIN, GLIQUIDONE, Placebo for Actos 15 mg tablets, METFORMIN HYDROCHLORIDE, METFORMIN HYDROCHLORIDE

Primary endpoint: Change from Baseline in HbA1c at Week 24 of the Treatment
Endpoint(s): Change from Baseline in HbA1c at Week 12 of the Treatment, Change from Baseline in fasting plasma glucose (FPG) at Week 12 and 24 of the Treatment, Proportion (%) of subjects who achieved HbA1c < 6.5% at Week 24 of the Treatment, Proportion (%) of subjects who achieved HbA1c < 7.0% at Week 24 of the Treatment, Change from Baseline in lipid profile (total cholesterol, LDL-C, HDL-C, and TG) levels at Week 12 and 24 of the Treatment, Change from Baseline in insulin resistance (HOMA-IR) and insulin secretion ability (HOMA-β) at Week 12 and 24 of the Treatment, Change from Baseline in liver function indicators (AST, ALT) at Week 12 and 24 of the Treatment, Proportion (%) of subjects who received a rescue medication at Week 12 and 24 of the Treatment, Change from Baseline in body weight at Week 12 and 24 of the Treatment, Change from Baseline in blood pressure (SBP, DBP) at Week 12 and 24 of the Treatment, Change from Baseline in heart rate at Week 12 and 24 of the Treatment, Change from Baseline in waist circumference at Week 12 and 24 of the Treatment

Source: https://euclinicaltrials.eu/ctis-public/view/2023-508924-36-00